EU clinical trial 2023-508529-29-00: A Phase 1 Dose Finding and Phase 2 Randomized, Open-Label Trial to Evaluate the Safety and Clinical Activity of Immunoradiotherapy Combinations as a Treatment Option for Subjects With Metastatic Solid Tumors
Protocol code: GCT1042-02
Sponsor: Genmab A/S (Pharmaceutical company). Phase: Phase I and Phase II (Integrated)- Other. Countries: France (ended).
Therapeutic area(s): Diseases [C] - Neoplasms [C04]
Gender: Female, Male. Age: 18-64 years, 65+ years. Enrolment: 88.
Status: Ended. Start date (EU): 2023-03-08. End date (EU): 2025-08-11. Decision date: 2024-08-07. Results received: Yes. Last updated: 2025-03-24.

Condition(s): Metastatic Solid Malignant tumors
Product: GEN1042 DP, PEMBROLIZUMAB

Primary endpoint: Part 1: Dose Limiting Toxicities (DLTs), Part 2: Number of Participants with Abscopal Response in Non-irradiated Target Lesions
Endpoint(s): Parts 1 and 2: Objective Response Rate (ORR) per RECIST v1.1 as assessed by investigator., Parts 1 and 2: Duration of Response (DOR) per RECIST v1.1 as assessed by investigator., Parts 1 and 2: Disease Control Rate (DCR) per RECIST v1.1 as assessed by investigator., Parts 1 and 2: Progression Free Survival (PFS) per RECIST v1.1 as assessed by investigator., Parts 1 and 2: Overall Survival (OS), Part 1: Number of Participants With Abscopal Response in Non-irradiated Target Lesions, Parts 1 and 2: Incidence and severity Adverse Events (AEs) and safety laboratory parameters., Parts 1 and 2: Pharmacokinetics (PK) parameter, Parts 1 and 2: Number of Participants with Anti-drug Antibodies (ADAs)

Source: https://euclinicaltrials.eu/ctis-public/view/2023-508529-29-00